EU clinical trial 2022-501026-37-00: Phase2, double-blind, randomized, placebo-controlled, multicentre study to evaluation the safety, efficacy, and pharmacokinetics of TAK-242 and Granulocyte Colony-Stimulating Factor (G-CSF) (G-TAK) in subjects with severe alcoholic hepatitis (sAH) and acute-on-chronic liver failure (ACLF).
Protocol code: G-TAK-ES-01
Sponsor: Alpha Bioresearch S.L., Yaqrit Limited (Pharmaceutical company). Phase: Therapeutic exploratory (Phase II). Countries: Germany (not authorised), Spain (not authorised), Portugal (not authorised).
Therapeutic area(s): Diseases [C] - Nutritional and Metabolic Diseases [C18]
Gender: Female, Male. Age: 18-64 years, 65+ years. Enrolment: 50.
Status: Not authorised. Decision date: 2023-03-30. Results received: No. Last updated: 2023-04-03.
Decision dates by country: DE: 2023-03-30, PT: 2023-04-03, ES: 2023-04-03

Condition(s): ACLF is a syndrome that occurs in patients with chronic liver disease, with or without previously diagnosed cirrhosis, which is characterized by acute hepatic decompensation resulting in liver failure (jaundice and prolongation of INR), one or more extrahepatic organ failures (renal, brain, coagulation, respiratory, cardiovascular), and is associated with increased mortality within 28-days and up to 3 months from onset. Grade 1 ACLF has a >15% risk of mortality at 28 days. The study population will consist of up to 78 subjects with Grade 1- 3 ACLF limited to 3 organ failures and a baseline CLIF-C ACLF-CRP score of >35 and <60.
Product: Resatorvid (TAK-242) concentrate for solution for infusion, PLACEBO, 20% Intralipid and 5% Dextrose, PLACEBO, Neupogen 30 MU (0.3 mg/ml) solution for injection filgrastim, Overall, 6 doses of g-csf or matching placebo will be administered subcutaneously on days 1-5 and additionally at day 8 (total 6 doses). the placebo for filgrastim will be supplied by the sponsor and will consist of the vehicle used in commercial filgrastim vials.

Primary endpoint: The percentage of subjects who experience at least 1 treatment-emergent AE (TEAE) or SAE., The percentage of subjects who discontinue the study drug due to an AE (including methemoglobinemia).
Endpoint(s): Change in CLIF-C OF score in subjects treated with G-TAK compared to placebo from baseline to Day 14. APPENDIX 2, Change in CLIF-C OF score in subjects treated with TAK-242 alone compared with G-TAK as well as CLIF C ACLF-CRP score between all arms, Define the pharmacokinetics of TAK-242 alone or the combination G-TAK in patients with ACLF: Plasma Cmax and Cav of TAK-242 and G-CSF and metabolites., To investigate the effects TAK-242 alone or the combination G-TAK compared with placebo and each other in subjects with sAH and ACLF on key biomarkers for inflammation, cell death, liver function, regeneration and senescence: Change in naturally log-transformed key biomarkers total bilirubin (TB), cleaved Cytokeratin-18 (M30)/ Cytokeratin-18 (M65), transforming growth factor beta 1 (TGFb1), interleukin 22 (IL-22) and interleukin 22 binding protein (IL-22BP), CRP, hepatic growth factor (HGF), SDF, To investigate the effect of a) TAK-242 alone or b) the combination TAK-242/G-CSF (G-TAK) on Day 28 and Day 84 transplant free and overall survival versus placebo in subjects with sAH and ACLF., To investigate the effect of TAK-242 alone or the combination G-TAK compared with placebo and each other administered for 10 days in subjects with sAH and ACLF on organ function (hepatic, renal, brain, coagulation, respiratory, cardiovascular): Regular assessments of organ failure, systemic inflammation, and ACLF including CLIF-C organ failure score (CLIF-C OF), CLIF-C acute decompensation score (CLIF-C AD), CLIF-C ACLF-CRP score and Systemic Inflammatory Response Score (SIRS) (APPENDIX 2 and AP, Change in inflammatory markers and ACLF-related panel including, but not limited to, IL-6, TNF-α, IL-10, M30/M65, sCD163, sCD206 from baseline to Day 4, 7 and 14., To investigate the effect of TAK-242 alone or the combination G-TAK compared with placebo and each other on the Quality of Life in subjects with sAH and ACLF. The scoring system that will be used is EQ5D5L, which allows assessment of QoL changes in sick patients (see APPENDIX 14)., Number of days in intensive care/intensive therapy unit., Total costs of hospital treatment with a time horizon of 90 days across treatment arms. The cost analysis is limited to hospital care.

Source: https://euclinicaltrials.eu/ctis-public/view/2022-501026-37-00